EU clinical trial 2025-524879-23-00: Epcoritamab in Relapsed/Refractory Marginalzone Lymphoma - A MULTICENTER OPEN LABEL SINGLE-ARM PHASE II STUDY (EPOS-1)
Protocol code: EPOS-1
Sponsor: Universitaetsklinikum Ulm AöR (Hospital/Clinic/Other health care facility). Phase: Therapeutic exploratory (Phase II). Countries: Germany (authorised, recruitment pending).
Therapeutic area(s): Diseases [C] - Hemic and Lymphatic Diseases [C15]
Gender: Female, Male. Age: 18-64 years, 65+ years. Enrolment: 53.
Status: Authorised, recruitment pending. Decision date: 2026-06-19. Results received: No. Last updated: 2026-06-19.

Condition(s): Marginal Zone Lymphoma
Product: Tepkinly 4 mg/0.8 ml solution for injection, Tepkinly 48 mg solution for injection

Primary endpoint: CR rate (CRR) determined 4 weeks after the end of treatment (after 12 cycles of treatment or in the case of early termination at the time point of the early termination visit)
Endpoint(s): Overall response rate (ORR) after12 cycles of treatment, Best response (BR): CR and ORR, Time to best response: CR, ORR, Time to first response: CR, ORR, Progression free survival (PFS), Time to treatment failure (TTF), Duration of Response (DR), Cause specific survival (CSS), Overall survival (OS), Quality of life, Safety

Source: https://euclinicaltrials.eu/ctis-public/view/2025-524879-23-00